EU clinical trial 2022-502426-41-00: Thromboprophylaxis in good and intermediate prognosis advanced germ cell tumors (GIG-T)
Protocol code: 2022/3510 GIG-T
Sponsor: Institut Gustave Roussy (Hospital/Clinic/Other health care facility). Phase: Therapeutic confirmatory (Phase III). Countries: France (ongoing, recruiting).
Therapeutic area(s): Diseases [C] - Male Urogenital Diseases [C12]; Diseases [C] - Neoplasms [C04]
Gender: Male. Age: 18-64 years. Enrolment: 387.
Status: Ongoing, recruiting. Start date (EU): 2023-10-17. Decision date: 2023-04-18. Results received: No. Last updated: 2026-01-13.
Decision dates by country: FR: 2023-04-20

Condition(s): Thromboprophylaxis in good and intermediate prognosis advanced germ cell tumors
Product: Fragmin® 5000 IU, Cisplatine Hospira 100 mg/100 ml Onco-Tain solution injectable, LOVENOX 4 000 UI (40 mg)/0,4 ml, solution injectable en seringue préremplie, INNOHEP 4 500 UI anti-Xa/0,45 ml, solution injectable en seringue préremplie

Primary endpoint: Proportion of patients undergoing a thromboembolic event (composite end point: venous or arterial thrombosis or embolism or unexplained death) occurring from randomization up to 6 weeks after D1 of the last cycle of chemotherapy or up to the residual masses surgery, whichever occurs first. Thromboembolic events will be reviewed by an independent clinical endpoint adjudication committee, blinded to the investigational treatment.
Endpoint(s): Time to first occurrence a thromboembolic event (composite end point: venous or arterial thrombosis or embolism or unexplained death) from randomization up to 6 weeks after Day 1 of the last cycle of chemotherapy or until residual masses surgery., Time to each component of the thromboembolic event composite endpoint from randomization up to 6 weeks after Day 1 of the last cycle of chemotherapy or until residual masses surgery., Safety parameters include bleedings (major and clinically relevant non-major in agreement with the International Society on Thrombosis and Haemostasis recommendations, classified by the blinded adjudication committee), incidence of heparin-induced thrombopcytopenia, transfusions requirements and other serious or non-serious adverse events and deaths graded using the NCI-CTCAE v5.0 (Common Terminology Criteria for Adverse Events), Comorbidity and need for hospitalization or extension of hospitalization length of stay (in patients already hospitalized for chemotherapy administration) for patients with TEE or adverse events related to thromboprophylaxis, Number of patients needed to treat to avoid a TEE., Time to first occurrence of a thromboembolic event from inclusion up to 6 weeks after the last dose of chemotherapy or until residual masses surgery in GCT patients not presenting the already identified risk factors (...) and in high-risk GCT patients from the control group. Thromboembolic events will be reviewed by an independent clinical endpoint adjudication committee, in low and high-risk patients. The independent committee will be blinded to th, Evaluation of CVC (central venous catheter) presence, physical inactivity, smoking habits, germ cell histology, IGCCCGC prognostic group and baseline laboratory covariates as TEE risk factors (including platelets, prothrombin time, partial thromboplastin time, albumin), Cost-effectiveness of thromboprophylaxis in high-risk patients, Proportion of patients undergoing symptomatic venous thrombosis,, Proportion of patients undergoing asymptomatic (incidental finding) venous thrombosis,, Proportion of patients undergoing pulmonary embolism, Proportion of patients with an unexplained death, The events taken into account for the computation of these proportions are those occurring from randomization up to 6 weeks after D1 of the last cycle of chemotherapy or up to the residual masses surgery,

Source: https://euclinicaltrials.eu/ctis-public/view/2022-502426-41-00